EU clinical trial 2023-506696-10-00: A Phase III, Randomized, Double-Blind Study of Tiragolumab Plus Atezolizumab Compared with Placebo Plus Atezolizumab in Participants with Completely Resected Stage IIB, IIIA, or Select IIIB, PD-L1 Positive, Non-Small Cell Lung Cancer who have received Adjuvant Platinum-Based Chemotherapy
Protocol code: GO45006
Sponsor: F. Hoffmann-La Roche AG (Pharmaceutical company). Phase: Therapeutic confirmatory (Phase III). Countries: Germany (ended), Austria (ended), Belgium (ended), Italy (ended), Poland (ended), Spain (ended), Romania (ended), Slovakia (ended), France (ended), Ireland (ended), Hungary (ended), Greece (ended).
Therapeutic area(s): Diseases [C] - Neoplasms [C04]
Gender: Female, Male. Age: 18-64 years, 65+ years. Enrolment: 576.
Status: Ended. Start date (EU): 2024-06-18. End date (EU): 2025-11-17. End date: 2025-12-16. Decision date: 2024-05-21. Results received: Yes. Last updated: 2025-11-05.
Decision dates by country: HU: 2024-05-23, AT: 2024-05-22, IE: 2024-05-24, PL: 2024-05-21, ES: 2024-05-24, GR: 2024-06-07, RO: 2024-05-24, BE: 2024-05-24, DE: 2024-05-22, SK: 2024-05-23, FR: 2024-05-23, IT: 2024-05-22

Condition(s): Non-Small Cell Lung Cancer

Primary endpoint: 1. Incidence and severity of adverse events, with severity determined according to NCI CTCAE v5.0

Source: https://euclinicaltrials.eu/ctis-public/view/2023-506696-10-00